EU clinical trial 2024-511427-34-00: Pragmatic management of progressive disease in idiopathic pulmonary fibrosis: a randomized trial. PROGRESSION-IPF
Protocol code: 69HCL19_0029
Sponsor: Hospices Civils De Lyon (Hospital/Clinic/Other health care facility). Phase: Therapeutic confirmatory (Phase III). Countries: France (ended).
Therapeutic area(s): Diseases [C] - Respiratory Tract Diseases [C08]
Gender: Female, Male. Age: 18-64 years, 65+ years. Enrolment: 378.
Status: Ended. Start date (EU): 2020-02-20. End date (EU): 2026-01-09. Decision date: 2024-04-11. Results received: No. Last updated: 2025-01-08.

Condition(s): idiopathic pulmonary fibrosis
Product: Esbriet 267 mg film-coated tablets, Ofev 150 mg soft capsules

Primary endpoint: Slope of the decline in the forced vital capacity (FVC) measured during 24 weeks by hospital spirometry performed on the same spirometer at baseline, week 4, week 12 and week 24.
Endpoint(s): Tolerance of antifibrotic therapy expressed as the proportion of patients who continue intent-to-treat therapy at week 24, at a minimal daily dose of two thirds of the full treatment dose (e.g. 200 mg/day of nintedanib and/or 1602 mg/day of pirfenidone), with temporary interruptions of no more than 28 consecutive days., Time to permanent study drug discontinuation, defined as the interval from study treatment randomization to study drug permanent discontinuation or the end of follow-up. Study drug discontinuation will be considered in case of permanent termination of drug treatment allocated by randomization, transient discontinuation for longer than 28 consecutive days, or dose reduction below two thirds of the full treatment dose (i.e. 200 mg per day of nintedanib or 1602 mg per day or pirfenidone)., Time to treatment failure, defined as the time from study treatment randomization to the first occurrence during the 24 weeks follow-up of any of the following events: o Death from any cause, o Non-elective hospitalization from pulmonary cause, o Acute exacerbation of idiopathic pulmonary fibrosis , o Decrease from baseline of ≥ 10% in FVC, o Permanent study drug discontinuation or the end of follow-up., Proportion of patients with ≥ 10% FVC relative decline or death at week 24, Hospitalization-free survival, defined as the time from randomization to the first occurrence during the 24 weeks follow-up of any of the following events: o Death from any cause, o All-cause unscheduled hospital admission, or the end of follow-up., Time from randomization to the first non-elective hospitalization from pulmonary cause (which is predefined by a set of criteria in protocol) during the 24 weeks follow-up or the end of follow-up., Time from randomization to death from any cause during the 24 weeks of the study or the end of follow-up., Progression of disease evaluated by the change from baseline in volume of fibrotic features at imaging by computed tomography assessed at 24 weeks., Time from randomization to initiation of supplementary oxygen therapy during the 24 weeks of the study or the end of follow-up., Time from randomization to acute exacerbation of idiopathic pulmonary fibrosis (idiopathic or triggered) during the 24 weeks of the study or the end of follow-up., Absolute change in IPF questionnaires relative to symptoms and impact on quality of life between baseline and week 24 assessed by : King’s Brief Interstitial Lung Disease Questionnaire (K-BILD), EQ-5D-5L Questionnaire, Living with Pulmonary Fibrosis (L-PF) Symptoms and Impact questionnaires, and analogy scale and Likert scale for the evaluation of dyspnea, cough and respiratory health.

Source: https://euclinicaltrials.eu/ctis-public/view/2024-511427-34-00